EU clinical trial 2024-515489-15-00: An Open-Label, Single Arm Study of the Safety, Pharmacokinetics, Pharmacodynamics, and Efficacy of Leniolisib in Pediatric Patients (Aged 4 to 11 Years) With APDS (Activated Phosphoinositide 3-Kinase Delta Syndrome) Followed by an Open-Label Long-Term Extension
Protocol code: LE 3301
Sponsor: Pharming Technologies B.V. (Pharmaceutical company). Phase: Therapeutic confirmatory (Phase III). Countries: France (ended).
Therapeutic area(s): Diseases [C] - Immune System Diseases [C20]
Gender: Female, Male. Age: 0-17 years. Enrolment: 6.
Status: Ended. Start date (EU): 2023-09-06. End date (EU): 2025-06-03. Decision date: 2024-10-01. Results received: No. Last updated: 2025-11-12.

Condition(s): Activated Phosphoinositide 3-Kinase Delta Syndrome
Product: CDZ173/Leniolisib, CDZ173/Leniolisib

Primary endpoint: Part I: • Incidence of treatment-emergent AEs (TEAEs), SAEs, and AEs leading to discontinuation of study drug, Part I: • Change from baseline in clinical laboratory test results (hematology, blood chemistry, urinalysis), Part I: • Change from baseline in vital signs, Part I: • Change from baseline in physical examination findings, Part I: • Change from baseline in electrocardiograms (ECGs), Part I: • Change from baseline in growth and physical development, Part I: • Reduction in lymphoproliferation as measured by MRI or low-dose CT at end of 12 weeks of treatment, Part I: • Immunophenotype normalization assessed by changes from baseline in the proportion of naïve B cells among all B cells to end of 12 weeks of treatment, Part II: • All safety parameters (including TEAEs, SAEs, Aes leading to discontinuation of study drug, physical examination, vital signs, ECGs, growth and physical development, and clinical laboratory results)
Endpoint(s): Part I: • popPK model that describes the appropriate covariates (eg, body weight and age) that influence leniolisib PK in pediatric patients (from baseline to end of 12 weeks of treatment), Part I: • Frequency of infections, use of antibiotics, and Ig replacement therapy, Part I: • Phosphorylated protein kinase B (pAKT) inhibition in whole blood, Part II: • Reduction in lymphoproliferation as measured by MRI or low-dose CT at 1 year, as measured by SPD of index and measurable non-index lesions selected as per the Cheson methodology, 3D volume and 3D sizes of spleen and liver, where appropriate, Part II: • Incidence of infections, use of antibiotics, and use of Ig replacement therapy

Source: https://euclinicaltrials.eu/ctis-public/view/2024-515489-15-00